EU clinical trial 2024-518325-15-00: A phase III multi-center, randomized, open-label study to evaluate the efficacy and safety of [177Lu]Lu-DOTA-TATE in patients newly diagnosed with Grade 1 and Grade 2 (Ki-67 <10%) advanced GEP-NET with high disease burden (NETTER-3)
Protocol code: CAAA601A62301
Sponsor: Novartis Pharma AG (Pharmaceutical company). Phase: Therapeutic confirmatory (Phase III). Countries: Italy (ongoing, recruiting), Poland (ongoing, recruiting), Germany (ongoing, recruiting), Spain (ongoing, recruiting), Hungary (ongoing, recruiting), France (ongoing, recruiting), Netherlands (ongoing, recruiting).
Therapeutic area(s): Diseases [C] - Neoplasms [C04]
Gender: Female, Male. Age: 0-17 years, 18-64 years, 65+ years. Enrolment: 100.
Status: Ongoing, recruiting. Start date (EU): 2025-09-08. Decision date: 2025-07-10. Results received: No. Last updated: 2026-04-24.
Decision dates by country: FR: 2025-07-15, HU: 2025-07-15, IT: 2025-07-16, PL: 2025-07-18, NL: 2025-07-15, ES: 2025-07-15, DE: 2025-07-10

Condition(s): Gastroenteropancreatic neuroendocrine tumor (GEP-NET)
Product: METOCLOPRAMIDE, SANDOSTATIN LAR 10 mg powder and solvent for suspension for injection, LysaKare 25 g/25 g solution for infusion, SANDOSTATIN LAR 20 mg powder and solvent for suspension for injection, SANDOSTATIN LAR 30 mg powder and solvent for suspension for injection, Lutathera 370 MBq/mL solution for infusion, OCTREOTIDE

Primary endpoint: PFS, defined as the time from randomization to the first occurrence of progression (centrally assessed by Blinded Independent Review Committee (BIRC) according to RECIST v1.1) or death due to any cause
Endpoint(s): Time to deterioration (by an absolute change of at least 15%), defined as the time from randomization to the first occurrence of deterioration compared to baseline scores or death from any cause for each of the following domains (tested separately) of EORTC QLQ-GI.NET21 [gastrointestinal scale (GI scale)] and EORTC QLQ-C30 questionnaires (fatigue, diarrhea, and global health scale)., PFS, defined as the time from randomization to the first occurrence of progression (Investigator assessed according to RECIST v1.1) or death due to any cause., Objective response rate (ORR): Rate of participants with best overall response (BOR) of partial response (PR) or complete response (CR) as per RECIST v1.1 (both Investigator and centrally assessed by BIRC)., Disease control rate (DCR): Rate of participants with BOR of PR, CR or stable disease (SD) as per RECIST v1.1 (both Investigator and centrally assessed by BIRC)., DOR: The time from initially meeting the criteria for response (CR or PR) until the time of progression according to RECIST v1.1 or death due to underlying disease only., Incidence and severity of adverse events (AEs) and serious adverse event (SAEs), changes in laboratory values, vital signs and ECGs. Tolerability: Dose interruptions, discontinuations, and reductions., OS: Time from the randomization date until the date of death due to any cause., • TTD (using the same definition as for key secondary endpoints) for EORTC QLQ-G.I.NET21 and EORTC QLQ-C30 domains not included among key secondary endpoints • Absolute change from baseline in EORTC QLQ-G.I.NET21 and EORTC QLQ-C30 domains. • Absolute change from baseline in the EQ-5D-5L index at each timepoint., Absorbed radiation dose in selected organs, tumor lesions and total body., PK parameters (Area Under Curve (AUC), clearance, distribution volume, half-life) from [177Lu]Lu-DOTA-TATE blood radioactivity data.

Source: https://euclinicaltrials.eu/ctis-public/view/2024-518325-15-00